EU clinical trial 2023-504245-32-00: A Phase 2, Double-blind, Randomized, Placebo-controlled Study to Investigate the Efficacy and Safety of NS-229 in the Treatment of Eosinophilic Granulomatosis With Polyangiitis
Protocol code: NS229-P2-01
Sponsor: Ns Pharma Inc. (Pharmaceutical company). Phase: Therapeutic exploratory (Phase II). Countries: Italy (ongoing, recruiting), France (ongoing, recruiting), Germany (ongoing, recruiting), Spain (ended).
Therapeutic area(s): Diseases [C] - Immune System Diseases [C20]
Gender: Female, Male. Age: 18-64 years, 65+ years. Enrolment: 20.
Start date (EU): 2024-06-06. Decision date: 2024-03-26. Results received: No. Last updated: 2026-05-29.
Decision dates by country: ES: 2024-03-26, DE: 2024-03-26, FR: 2024-03-26, IT: 2024-03-28

Condition(s): Eosinophilic granulomatosis with polyangiitis (EGPA)
Product: NS-229, NS-229 matching tablets with no active treatment

Primary endpoint: Primary Efficacy Endpoint: The proportion of subjects in remission (oral glucocorticoid [OGC] 4.0) at Week 28 of the study treatment period., Primary Safety Endpoints: Number of adverse events (AEs) including AEs that may be treatment-related and severe reactions, some of which may be treatment-related.
Endpoint(s): Secondary Efficacy Endpoints: The proportion of subjects in remission (OGC 7.5) at Week 28 of the study treatment period, Secondary Efficacy Endpoints: Time to first relapse of EGPA (active disease since the last visit after achieved decrease), Secondary Efficacy Endpoints: Time to first worsening of EGPA (worsening of active disease since the last visit)

Source: https://euclinicaltrials.eu/ctis-public/view/2023-504245-32-00